EU clinical trial 2024-510974-25-00: A Phase IV, Multicenter, Open-Label Study Evaluating B-Cell Levels in Infants Potentially Exposed to Ocrelizumab During Pregnancy – The MINORE Study
Protocol code: MN42988
Sponsor: F. Hoffmann-La Roche AG (Pharmaceutical company). Phase: Therapeutic use (Phase IV). Countries: Spain (ended), Germany (ended).
Therapeutic area(s): Diseases [C] - Nervous System Diseases [C10]
Gender: Female, Male. Age: 18-64 years. Enrolment: 10.
Status: Ended. Start date (EU): 2021-11-10. End date (EU): 2025-05-15. End date: 2025-07-14. Decision date: 2024-04-23. Results received: Yes. Last updated: 2024-09-26.
Decision dates by country: DE: 2024-04-26, ES: 2024-04-23

Condition(s): Multiple Sclerosis (MS) or Clinically Isolated Syndrome (CIS) [in line with the locally approved indications]
Product: Ocrevus 300 mg concentrate for solution for infusion

Primary endpoint: 1. Proportion of infants with B-cell levels (CD19+ cells, absolute counts) below the lower limit of normal (LLN), measured at week 6 of life
Endpoint(s): 1. B-cell levels (CD19+ cells, absolute counts and percentage of lymphocytes) measured at week 6 of life, 2. Serum concentration of ocrelizumab in the umbilical cord blood at birth, 3. Serum concentration of ocrelizumab in the infant at week 6 of life, 4. Mean titers of antibody immune response(s) to vaccination to common childhood vaccinations with full or partial doses given prior to 1 year, which include responses to diphtheria, tetanus, pertussis, Hib, PCV-13, MMR, and HBV, 5. Proportion of infants with positive humoral response (seroprotective titers; as defined for the individual vaccine) to vaccines, 6. Serum concentration of ocrelizumab in the mother during pregnancy (time frame of blood sampling: Week 24-30, Week 35) and at delivery (time frame of blood sampling: within 24 hours after delivery), 7. Rate and nature of adverse events (AEs) in the mother throughout the study, including changes in clinical and laboratory results, 8.Rate and nature of AEs in the infant throughout the study, including infections and hospitalizations, 9. Proportion of pregnancies resulting in live births (term and preterm, with and without congenital anomalies), therapeutic abortions, or stillbirths, 10. Infant characteristics at birth, including but not limited to body weight, head circumference and length

Source: https://euclinicaltrials.eu/ctis-public/view/2024-510974-25-00